EU clinical trial 2022-502405-15-01: Early treatment intensification in patients with high risk Mantle Cell Lymphoma using CAR-T-cell treatment after an abbreviated induction therapy with Rituximab and Ibrutinib and 6 months Ibrutinib maintenance (Arm A) as compared to standard of care induction and maintenance (Arm B)
Protocol code: CARMAN
Sponsor: Klinikum Der Universitat Munchen AöR (Hospital/Clinic/Other health care facility). Phase: Therapeutic exploratory (Phase II). Countries: Germany (ongoing, recruiting), Spain (ongoing, recruiting), Czechia (ongoing, recruiting), France (ongoing, recruiting), Netherlands (ongoing, recruiting).
Therapeutic area(s): Diseases [C] - Neoplasms [C04]
Gender: Female, Male. Age: 18-64 years, 65+ years. Enrolment: 150.
Status: Ongoing, recruiting. Start date (EU): 2024-04-08. Decision date: 2024-08-12. Results received: No. Last updated: 2026-03-06.
Decision dates by country: NL: 2024-10-18, CZ: 2024-08-30, ES: 2024-08-12, DE: 2023-11-27, FR: 2024-12-19

Condition(s): Mantle Cell Lymphoma (MCL)
Product: DOXORUBICIN, RITUXIMAB, FILGRASTIM, CYCLOPHOSPHAMIDE, THIOTEPA, TOCILIZUMAB, DEXAMETHASONE, VINCRISTINE SULFATE, OXALIPLATIN, BENDAMUSTINE, PEGFILGRASTIM, FLUDARABINE, ETOPOSIDE, CARMUSTINE, CISPLATIN, Tecartus 0.4 - 2 x 10e8 cells dispersion for infusion, MELPHALAN, PREDNISOLONE, CYTARABINE, IMBRUVICA 140 mg hard capsules

Primary endpoint: Failure-free survival (FFS) from randomization. Failure events are defined as the earliest of the following: o Stable disease at the end of induction (Arm B, or Arm A if CAR-T-cells are not infused) or within 12 weeks from CAR-T-cell infusion (Arm A), o Progressive disease at or at any time after end of induction treatment, and o Death from any cause at any time
Endpoint(s): Progression-free survival (PFS) from randomization, Complete remission (CR) rate and overall response rate (ORR: CR, PR) approx. 6.5 months from randomization, Rate of PET negative CR (complete metabolic response rate, per Lugano criteria) approx. 6.5 months from randomization, PFS in responders approx. 6.5 months from randomization (landmark analysis), Best response within 2 years from randomization, Time to best response and time to first response from randomization, Overall survival (OS) from randomization, Safety: adverse events, serious adverse events, graded according to CTCAE

Source: https://euclinicaltrials.eu/ctis-public/view/2022-502405-15-01